EU clinical trial 2023-507528-21-00: A Multicenter, Randomized, Double blind, Vehicle-controlled, Phase 3 Efficacy and Safety Study of Patidegib Gel 2% for the Reduction of Disease Burden of Persistently Developing Basal Cell Carcinomas (BCCs) in Subjects with Gorlin Syndrome
Protocol code: SGT-610-01
Sponsor: Sol-Gel Technologies Ltd. (Pharmaceutical company). Phase: Therapeutic confirmatory (Phase III). Countries: Netherlands (ended), France (ongoing, recruitment ended), Italy (ended), Spain (ongoing, recruitment ended), Poland (ended), Germany (ended).
Therapeutic area(s): Diseases [C] - Congenital, Hereditary, and Neonatal Diseases and Abnormalities [C16]
Gender: Female, Male. Age: 18-64 years, 65+ years. Enrolment: 60.
Start date (EU): 2024-05-23. Decision date: 2024-04-11. Results received: No. Last updated: 2026-05-27.
Decision dates by country: PL: 2024-04-15, NL: 2024-04-15, DE: 2024-04-24, FR: 2024-04-16, IT: 2024-04-16, ES: 2024-04-11

Condition(s): Gorlin Syndrome
Product: Patidegib Gel, Vehicle Gel

Primary endpoint: Number of new BCCs at Month 12 in the 2 arms (Patidegib Gel 2% and vehicle) on the face of subjects with Gorlin syndrome as assessed by the CPRB
Endpoint(s): Number of New Surgically Eligible BCCs (nSEBs) at Month 12 in the 2 arms (Patidegib Gel 2% and vehicle) on the face of subjects with Gorlin syndrome as assessed by the CPRB, Change from Baseline to Month 12 in Advanced Basal Cell Carcinoma Index (aBCCdex) lesion symptoms scale score, Change from Baseline to Month 12 in confirmed BCCs lesion diameter, Proportion of Surgically Eligible BCCs (SEBs) and nSEBs assessed as resolved by Month 12, Proportion of SEBs and nSEBs per subject that have regressed by Month 12, Proportion of subjects developing ≥2 facial new BCCs at Month 12, Change in total number of confirmed BCCs from Baseline to Month 12, Change from Baseline to Month 12 in the Skin Cancer Index quality of life questionnaire score, Adverse events (AEs), including serious adverse events (SAEs) occurring at any time during the study, Investigator Dermal Safety and Local Tolerability Assessments score at any time during the study, Change from Baseline to Month 12 in Patient Global Impression in disease Severity (PGI-S), Change in Patient Global Impression of Change in clinical status (PGI C) at Month 12, Number of new BCCs at Month 12 in the 2 arms (Patidegib Gel 2% and vehicle) on the face of subjects with Gorlin syndrome, Number of nSEBs at Month 12 in the 2 arms (Patidegib Gel 2% and vehicle) on the face of subjects with Gorlin syndrome in the ITT analysis set for this study (SGT 610 01), Time to first new BCC, Skin pain and peak pruritus scores as reported by the subject on a numeric rating scale, Number of nSEBs at Month 12 in the 2 arms (Patidegib Gel 2% and vehicle) on the face of subjects with Gorlin syndrome in the pooled ITT analysis set from this study (SGT-610-01) and the pre-specified ITT subset of Study Pelle-926-301 restricted to subjects who met SGT 610-01 inclusion criteria

Source: https://euclinicaltrials.eu/ctis-public/view/2023-507528-21-00